EU clinical trial 2026-525838-32-00: Morphine for resting breathlessness in severe illness and palliative care (MORE-B): a randomized clinical trial
Sponsor: Region Skane (Hospital/Clinic/Other health care facility). Phase: Therapeutic use (Phase IV). Countries: Sweden (authorised, recruitment pending).
Therapeutic area(s): Diseases [C] - Respiratory Tract Diseases [C08]
Gender: Female, Male. Age: 18-64 years, 65+ years. Enrolment: 40.
Status: Authorised, recruitment pending. Decision date: 2026-06-24. Results received: No. Last updated: 2026-06-24.

Condition(s): Serious, chronic, life-limiting disease
Product: Natriumklorid Fresenius Kabi 9 mg/ml infusionsvätska, lösning, Morfin Abcur, 10 mg/ml, injektionsvätska, lösning

Primary endpoint: Self-rated breathlessness (ESAS-r) [21, 22] change from baseline at 60 minutes after the treatment was administered.
Endpoint(s): Self-rated breathlessness (ESAS-r), change from baseline at 30 minutes after the treatment was administered, Change from baseline for other symptoms (pain, tiredness, drowsiness, nausea, lack of appetite, depression, anxiety, wellbeing) self-rated using the ESAS-r, change from baseline at 60 minutes after the treatment was administered, Safety measures (SpO2, breathing rate, and level of consciousness [GCS]) change from baseline at 60 minutes after the treatment was administered, Adverse drug reactions (ADRs), defined as adverse events assessed as possibly or probably related to the investigational medicinal product and excluding events attributable to the natural course of the underlying disease, will be recorded at 60 minutes after treatment administration, prior to the next dose, and at the end of the trial., Date, place and cause(s) of death up to three months after date of first randomization in the trial

Source: https://euclinicaltrials.eu/ctis-public/view/2026-525838-32-00